EU clinical trial 2025-521166-95-00: TMSxDCS: Pharmacologically augmenting transcranial magnetic stimulation for depression
Sponsor: Universiteit Maastricht (Educational Institution). Phase: Therapeutic exploratory (Phase II). Countries: Netherlands (authorised, recruitment pending).
Therapeutic area(s): Psychiatry and Psychology [F] - Mental Disorders [F03]
Gender: Female, Male. Age: 18-64 years. Enrolment: 48.
Status: Authorised, recruitment pending. Decision date: 2025-06-02. Results received: No. Last updated: 2025-06-02.

Condition(s): Major Depressive Disorder (MDD)
Product: Determination of what placebo is adequate to ensure blinding will be done at a later stage(amendment), as discussed in correspondence with the relevant METC., CYCLOSERINE

Primary endpoint: Percentage reduction from baseline MADRS score measured weekly for 6 weeks post-treatment
Endpoint(s): Percentage reduction from baseline MADRS-score at 6 months follow-up., Clinical remission (defined as a MADRS-score of ≤8) and clinical response (defined as a reduction from baseline MADRS score of >50%) at 6 weeks follow-up., Percentage reduction from baseline GAD-7-score measured weekly for the first 6 weeks post-treatment and monthly for the remainder of 6 months., Percentage reduction from baseline PHQ-9-score measured weekly for the first 6 weeks post-treatment and monthly for the remainder of 6 months., Change in performance on the cognitive test battery at 1 week follow-up., Side effect questionnaire taken immediately after treatment., EQ5D questionnaire taken at 6 weeks follow-up.

Source: https://euclinicaltrials.eu/ctis-public/view/2025-521166-95-00